EU clinical trial 2022-502940-10-00: Tuvusertib (M1774) Human Mass Balance and Absolute Bioavailability Study (DDRIVER Solid Tumors 303)
Protocol code: MS201924_0003
Sponsor: Merck Healthcare KGaA (Pharmaceutical company). Phase: Human Pharmacology (Phase I)- Other. Countries: Hungary (ended).
Therapeutic area(s): Diseases [C] - Neoplasms [C04]
Gender: Female, Male. Age: 18-64 years, 65+ years. Enrolment: 12.
Status: Ended. Start date (EU): 2024-02-23. End date (EU): 2026-04-14. Decision date: 2024-02-01. Results received: No. Last updated: 2026-01-29.

Condition(s): Advanced Solid Tumors

Source: https://euclinicaltrials.eu/ctis-public/view/2022-502940-10-00